EU clinical trial 2023-504192-25-00: Evaluating efficacy and safety of switching a boosted protease inhibitor to fostemsavir in PLWH with limited therapeutic options (FOST Switch)
Protocol code: NEAT808
Sponsor: NEAT ID Foundation (Patient organisation/association). Phase: Therapeutic use (Phase IV). Countries: Italy (ongoing, recruitment ended), Spain (ongoing, recruitment ended).
Therapeutic area(s): Diseases [C] - Virus Diseases [C02]
Gender: Female, Male. Age: 18-64 years, 65+ years. Enrolment: 45.
Status: Ongoing, recruitment ended. Start date (EU): 2024-06-05. Decision date: 2024-01-25. Results received: No. Last updated: 2026-07-24.
Decision dates by country: ES: 2025-03-10, IT: 2024-01-25

Condition(s): HIV-1
Product: Rukobia 600 mg prolonged-release tablets

Primary endpoint: To assess the proportion of patients with confirmed HIV viral load ≥50 copies/mL at week 48
Endpoint(s): Rates of individuals with VL < 50 copies/mL at week 24 (FDA Snapshot algorithm), Rates of individuals with VL < 50 copies/mL at week 48 (FDA Snapshot algorithm), Rates of individuals with VL < 200 copies/mL at week 24 (FDA Snapshot algorithm), Rates of individuals with VL < 200 copies/mL at week 48 (FDA Snapshot algorithm), CD4 count, CD4:CD8 ratio and Lymphocyte subsets (CD4 and CD8) at week 48., To evaluate the potential for drug-drug interactions in those who switch from their cART to Fostemsavir based on the University of Liverpool Drug interaction website or other sources of drug interaction knowledge, including prescribed drugs, hormones, over-the-counter medications and recreational drugs., Occurrence of adverse events, severity of adverse events and occurrence of treatment discontinuations due to tolerability of treatment., Safety and tolerability of Fostemsavir in the studied population, including lipids, glucose, insulin resistance (HOMA-IR) and weight, change in waist circumference., Patient reported benefits of switching. To describe changes in the quality of life and perception of health (patient reported outcomes will be collected following the administration of specific questionnaires (including wellness thermometer, PHQ9, and GAD-7) in relation to the drug switch)., To assess change from baseline in clinical outcomes (e.g., bone health by FRAX, kidney function; cardiovascular risk, weight, BMI, and waist circumference by equation calculation). Data will be collected from routine care clinical records.

Source: https://euclinicaltrials.eu/ctis-public/view/2023-504192-25-00